EU clinical trial 2024-518875-73-00: Randomised, double-blind, placebo-controlled study to evaluate the effect of metformin, an AMPK activator, on cognitive measures of progression in Huntington's disease patients.
Protocol code: TEMET-HD
Sponsor: IIS La Fe (Laboratory/Research/Testing facility). Phase: Therapeutic confirmatory (Phase III). Countries: Spain (ended).
Therapeutic area(s): Diseases [C] - Nervous System Diseases [C10]
Gender: Female, Male. Age: 18-64 years, 65+ years. Enrolment: 60.
Status: Ended. Start date (EU): 2021-12-10. End date (EU): 2025-06-10. Decision date: 2024-12-11. Results received: Yes. Last updated: 2024-12-11.

Condition(s): Huntington Disease
Product: DUMMY METFORMINE 850 mg COATED TABLETS, Metformina Galenicum 850 mg comprimidos recubiertos con película EFG

Primary endpoint: The tests that make up this subscale are the Symbol Digit Modalities Test, verbal fluency under phonetic command with the letters F, A and S, colour naming, word naming and interference in the Stroop test. The sum of the raw scores obtained makes up the UHDRS cognitive score, which is the primary endpoint of this study.

Source: https://euclinicaltrials.eu/ctis-public/view/2024-518875-73-00